EU clinical trial 2023-507860-37-00: "FAP-IT" 68Ga-FAPI-46 PET/CT for predicting histological response to neoadjuvant chemo-immunotherapy in triple-negative breast cancer
Protocol code: IC 2022-07
Sponsor: Institut Curie (Hospital/Clinic/Other health care facility). Phase: Phase I and Phase II (Integrated)- Other. Countries: France (ongoing, recruiting).
Therapeutic area(s): Analytical, Diagnostic and Therapeutic Techniques and Equipment [E] - Diagnosis [E01]; Diseases [C] - Neoplasms [C04]
Gender: Female, Male. Age: 18-64 years, 65+ years. Enrolment: 300.
Status: Ongoing, recruiting. Start date (EU): 2024-10-14. Decision date: 2024-04-12. Results received: No. Last updated: 2025-11-10.
Decision dates by country: FR: 2024-04-15

Condition(s): Breast cancer
Product: Paclitaxel Kabi 6 mg/ml koncentrátum oldatos infúzióhoz, KEYTRUDA 25 mg/mL concentrate for solution for infusion, CARBOPLATINE MEDAC 10 mg/mL, solution à diluer pour perfusion, 68Ga-FAPI-46, DOXORUBICINE ARROW 2 mg/ml, solution pour perfusion, Epirubicin Eugia 2 mg/ml oplossing voor injectie, Cyclophosphamid beta 500 mg/ml Konzentrat zur Herstellung einer Injektions-/Infusionslösung

Primary endpoint: To measure the performance of 68Ga-FAPI-46 PET/CT imaging to predict complete histological response after neoadjuvant chemotherapy plus Pembrolizumab, in terms of Area under the ROC curve (AUC of the ROC curve)..
Endpoint(s): Comparison of 68Ga-FAPI-46 PET/CT and 18F-FDG PET/CT performances for: - detection of metastases (using the total number of metastatic lesion), - Evaluation of the tumor burden (using the total FAP expression tumor volume/TFTV* and the total metabolic tumor volume/TMTV*, respectively)., Comparison of 68Ga-FAPI-46 PET/CT and 18F-FDG PET/CT predictive performances, separately and combined (association of biomarkers extracted from 68Ga-FAPI-46 PET/CT imaging, 18F-FDG PET/CT imaging with response to treatment)., Comparison of 68Ga-FAPI-46 PET/CT and 18F-FDG PET/CT prognostic performances, separately and combined (association of biomarkers extracted from 68Ga-FAPI-46 PET/CT imaging, 18F-FDG PET/CT imaging with recurrence and/or death from breast cancer)., Assessment of the predictive model performance combining 68Ga-FAPI-46 PET/CT and 18F-FDG PET/CT imaging data using sensitivity, specificity, positive and negative predictive values and area under curve the ROC curve(AUC of the ROC curve)., Exploratory: Correlation of 68Ga-FAPI-46 PET/CT imaging data with histological evaluation of CAF subpopulations (immunohistochemical staining for FAP), immune microenvironment (PD-L1 staining and TILs analysis) and comparison of the sensibility of 68Ga-FAPI-46 PET/CT imaging with that of histology., Exploratory: Quantitative analyze of circulating tumor DNA (ctDNA) before and after neoadjuvant treatment (pre-surgery), and correlation of them with biomarkers extracted from initial PET/CT scans (68Ga-FAPI-46 + 18F-FDG) on the one hand, and histological response on the other.

Source: https://euclinicaltrials.eu/ctis-public/view/2023-507860-37-00